EU clinical trial 2023-504918-29-00: An Open-label, Randomized Phase 3 Study of MK-2870 as a Single Agent and in Combination with Pembrolizumab Versus Treatment of Physician’s Choice in Participants with HR+/HER2- Unresectable Locally Advanced or Metastatic Breast Cancer
Protocol code: MK-2870-010
Sponsor: Merck Sharp & Dohme LLC (Pharmaceutical company). Phase: Therapeutic confirmatory (Phase III). Countries: Spain (ongoing, recruiting), Greece (ongoing, recruiting), Romania (ongoing, recruitment ended), Portugal (ongoing, recruiting), Ireland (ongoing, recruiting), Denmark (ongoing, recruiting), Norway (ended), Czechia (ongoing, recruiting), Italy (ongoing, recruiting), Belgium (ongoing, recruiting), Hungary (ongoing, recruiting), France (ongoing, recruiting), Sweden (ongoing, recruiting), Netherlands (ongoing, recruiting), Germany (ongoing, recruiting), Poland (ongoing, recruitment ended).
Therapeutic area(s): Diseases [C] - Neoplasms [C04]
Gender: Female, Male. Age: 18-64 years, 65+ years. Enrolment: 450.
Start date (EU): 2024-08-22. Decision date: 2024-05-13. Results received: No. Last updated: 2026-08-06.
Decision dates by country: NO: 2024-05-15, IT: 2024-05-14, FR: 2024-05-16, IE: 2024-05-17, GR: 2024-05-20, CZ: 2024-05-14, PL: 2024-05-20, SE: 2024-05-20, RO: 2024-06-06, ES: 2024-05-17, HU: 2024-05-16, NL: 2024-05-21, DE: 2025-06-25, PT: 2024-05-13, BE: 2024-05-15, DK: 2024-05-13

Condition(s): Hormone receptor positive breast cancer
Product: PARACETAMOL, MK-2870, DOXORUBICIN HYDROCHLORIDE, LIPOSOMAL, DOXORUBICIN, KEYTRUDA 25 mg/mL concentrate for solution for infusion, PACLITAXEL, CAPECITABINE, PACLITAXEL ALBUMIN-BOUND, DEXAMETHASONE, MK-2870

Primary endpoint: Progression-Free Survival (PFS) (MK-2870 versus treatment of physician’s choice [TPC]; MK-2870 + pembrolizumab versus TPC)
Endpoint(s): 1. Overall Survival (OS), 2. Progression-Free Survival (PFS) (MK-2870 + pembrolizumab versus MK-2870), 3. Objective Response Rate (ORR), 4. Duration of Response (DOR), 5. Change from baseline in global health status/quality of life scores, on the European Organization for the Research and Treatment of Cancer Quality of Life Questionnaire Core 30 (EORTC QLQ-C30), 6. Change from baseline in physical functioning score, on the EORTC QLQ-C30, 7. Change from baseline in emotional functioning score, on the EORTC QLQ-C30, 8. Change from baseline in fatigue score, on the EORTC QLQ-C30, 9. Change from baseline in diarrhea score, on the EORTC QLQ-C30, 10. Time to first Deterioration (TTD) in global health status/quality of life scores, on the EORTC QLQ-C30, 11. TTD in physical functioning score, on the EORTC QLQ-C30, 12. TTD in emotional functioning score, on the EORTC QLQ-C30, 13. TTD in fatigue score, on the EORTC QLQ-C30, 14. TTD in diarrhea score, on the EORTC QLQ-C30, 15. Number of participants who experience one or more Adverse Events (AEs), 16. Number of participants who discontinue study treatment due to an AE

Source: https://euclinicaltrials.eu/ctis-public/view/2023-504918-29-00